EU clinical trial 2024-516236-10-00: BARBICAN: A randomised, open-label Phase II study to determine the contribution of ipatasertib to neoadjuvant chemotherapy plus atezolizumab in women with triple-negative breast cancer
Protocol code: BARBICAN
Sponsor: Queen Mary University Of London (Educational Institution). Phase: Therapeutic exploratory (Phase II). Countries: Spain (authorised, recruitment pending), Germany (authorised, recruitment pending).
Therapeutic area(s): Diseases [C] - Neoplasms [C04]
Gender: Female. Age: 18-64 years, 65+ years. Enrolment: 109.
Status: Authorised, recruitment pending. Decision date: 2024-10-08. Results received: No. Last updated: 2025-07-03.
Decision dates by country: DE: 2024-10-14, ES: 2024-10-08

Condition(s): Triple-negative breast cancer
Product: Tecentriq 1 200 mg concentrate for solution for infusion, Ipatasertib

Primary endpoint: Clinical: • pCR is defined as no microscopic evidence of residual invasive tumour in all resected specimens of the breast and axilla (ypT0/is ypN0) in all patients. • pCR is defined as no microscopic evidence of residual invasive tumour in all resected specimens of the breast and axilla (ypT0/is ypN0) in patients with or without PIK3CA/AKT1/PTEN genetic alterations., Biological: 2-fold increase in GzmB+ CD8+ T cell levels from baseline to the end of each treatment phase.
Endpoint(s): • Objective response rate (ORR) as assessed by RECIST 1.1 principles, defined as percentage of subjects with best overall response of complete response (CR) or partial response (PR) in the relevant analysis population., • ORR., • Status and changes of the biomarkers listed below in pre- and end-of treatment tumour and/or blood samples: immune phenotyping, CD8, PD-L1 & MHC-I, immune infiltrates (IFNγ gene signature expression)., • IEFS, defined as the time from randomisation to date of first treatment failure that is invasive loco‐regional or distant recurrence or new invasive cancer or death from any cause. IEFS is further detailed according to the standardized STEEP system definition, • DEFS, defined as the time from randomisation to the date of first distant recurrence or death attributable to any cause, including breast cancer, non‐breast cancer, or unknown cause. Distant recurrence is defined as metastatic disease‐breast cancer that has either been biopsy confirmed or clinically diagnosed as recurrent invasive breast cancer., • OS, defined as time from randomisation to death of any cause., • Assessment of mean changes in function and disease/treatment-related symptoms in all scales of the EORTC QLQ-C30 by treatment arm., • Health utility assessment as measured by the EQ-5D during the study for health economic evaluations., • Incidence, nature and severity of adverse events with severity determined according to CTCAE v4.03.

Source: https://euclinicaltrials.eu/ctis-public/view/2024-516236-10-00